EU clinical trial 2024-511650-50-00: C2321014: A PHASE 3, RANDOMIZED, OPEN-LABEL STUDY OF PF-06821497 (MEVROMETOSTAT) IN COMBINATION WITH ENZALUTAMIDE COMPARED WITH ENZALUTAMIDE OR DOCETAXEL IN PARTICIPANTS WITH METASTATIC CASTRATION RESISTANT PROSTATE CANCER PREVIOUSLY TREATED WITH ABIRATERONE ACETATE (MEVPRO-1)
Protocol code: C2321014
Sponsor: Pfizer Inc. (Pharmaceutical company). Phase: Therapeutic confirmatory (Phase III). Countries: Czechia (ongoing, recruitment ended), Germany (ongoing, recruitment ended), Netherlands (ongoing, recruitment ended), France (ongoing, recruitment ended), Slovakia (ongoing, recruitment ended), Spain (ongoing, recruitment ended), Poland (ongoing, recruitment ended), Italy (ongoing, recruitment ended), Hungary (ongoing, recruitment ended), Sweden (ongoing, recruitment ended), Greece (ongoing, recruitment ended).
Therapeutic area(s): Not possible to specify
Gender: Male. Age: 18-64 years, 65+ years. Enrolment: 205.
Status: Ongoing, recruitment ended. Start date (EU): 2025-01-17. Decision date: 2024-12-10. Results received: No. Last updated: 2026-06-17.
Decision dates by country: HU: 2024-12-13, SE: 2024-12-16, IT: 2024-12-16, GR: 2024-12-10, CZ: 2024-12-11, NL: 2024-12-10, SK: 2024-12-13, ES: 2024-12-12, PL: 2024-12-16, FR: 2024-12-12, DE: 2024-12-10

Condition(s): METASTATIC CASTRATION RESISTANT PROSTATE CANCER
Product: PF-06821497, Xtandi - 40 mg soft capsules, DEXAMETHASONE, PF-06821497, PREDNISOLONE, DEXAMETHASONE, DOCETAXEL

Primary endpoint: BICR assessed rPFS per RECIST v1.1 (soft tissue disease) and PCWG3 (bone disease).
Endpoint(s): OS (alpha protected)., Proportion of participants with measurable soft tissue disease at baseline with an objective response per RECIST v1.1 (assessed by BICR)., Duration of response in soft tissue disease per RECIST v1.1 (assessed by BICR)., Proportion of participants with PSA response ≥50% in participants with detectable PSA values at baseline., Time to PSA progression., Time to initiation of new antineoplastic therapy., Time to first symptomatic skeletal event., PFS2 based on investigator assessment, Type, incidence, severity (as graded by NCI CTCAE v5.0), seriousness and relationship to study medications of AEs., Change from baseline in patient reported pain symptoms per BPI-SF, Change from baseline in HRQoL, functioning and symptoms per FACT-P, Change from baseline in patient reported health status per EQ-5D-5L, Symptomatic toxicity and the overall side effect burden as measured by items from the Patient-Reported Outcome CTCAE (PRO-CTCAE) and FACT-GP5, Time to confirmatory deterioration in patient-reported pain symptoms per BPISF Item 3 “worst pain in 24 hours”, Time to definitive deterioration in patientreported HRQoL and physical well-being per FACT-P., PK characterized by pre-dose trough and post-dose plasma concentrations of PF- 06821497 at selected visits., ctDNA burden at baseline and on study.

Source: https://euclinicaltrials.eu/ctis-public/view/2024-511650-50-00